EU clinical trial 2025-521405-40-01: Remifentanil versus rocuronium for optimizing video laryngoscopy assisted tracheal intubation in patients undergoing general anaesthesia - a multicentre randomised controlled trial The ROCVIDEO trial
Sponsor: Nordsjaellands Hospital (Hospital/Clinic/Other health care facility). Phase: Phase III and phase IV (Integrated). Countries: Denmark (ongoing, recruiting), Sweden (authorised, recruitment pending).
Therapeutic area(s): Analytical, Diagnostic and Therapeutic Techniques and Equipment [E] - Equipment and Supplies [E07]; Analytical, Diagnostic and Therapeutic Techniques and Equipment [E] - Anesthesia and Analgesia [E03]
Gender: Female, Male. Age: 18-64 years. Enrolment: 3184.
Start date (EU): 2025-11-12. Decision date: 2025-09-22. Results received: No. Last updated: 2026-06-23.
Decision dates by country: DK: 2025-09-22, SE: 2026-06-23

Condition(s): Adult patients undergoing tracheal intubation using video laryngoscopy.
Product: Remifentanil Fresenius Kabi, Rocuronium Fresenius Kabi

Primary endpoint: Safety: A composite of one or more intubation or anaesthesia-related adverse events: Early (< 20 min): Cardiac arrest, anaphylaxis, pulmonary aspiration, serious traumatic airway injury, desaturation, major hemodynamic event, new onset bradycardia, sustained new arrhythmia Late (< 24 h): Death, brain damage including stroke, acute myocardial infarction, ICU admission, re-intubation, postoperative respiratory failure, intraoperative awareness, pneumonia, dental injury, sore throat, or hoarsenes, Efficacy: Prevalence of failed first-pass intubation. Defined as failed tracheal tube delivery after the first attempt to introduce the video laryngoscope into the patient’s mouth.

Source: https://euclinicaltrials.eu/ctis-public/view/2025-521405-40-01